EU clinical trial 2024-511832-29-00: A Randomized, open-label, Phase 2 Study of Adjuvant Apalutamide or Standard of Care in Subjects with High-risk, Localized or Locally Advanced Prostate Cancer After Radical Prostatectomy
Protocol code: UKM17_0018
Sponsor: Universitaet Muenster (Educational Institution). Phase: Therapeutic exploratory (Phase II). Countries: Austria (ongoing, recruitment ended), Germany (ongoing, recruitment ended).
Therapeutic area(s): Diseases [C] - Neoplasms [C04]
Gender: Male. Age: 18-64 years, 65+ years. Enrolment: 190.
Status: Ongoing, recruitment ended. Start date (EU): 2020-08-05. Decision date: 2024-09-20. Results received: No. Last updated: 2026-01-16.
Decision dates by country: DE: 2024-09-20, AT: 2024-09-22

Condition(s): High risk adenocarcinoma of the prostate after radical prostatectomy (RPE)
Product: JNJ-56021927

Primary endpoint: Progression-free survival (PFS). This endpoint is defined as time interval from randomization until BCR, metastases, or death from any cause, whichever occurs first.

Source: https://euclinicaltrials.eu/ctis-public/view/2024-511832-29-00